EU clinical trial 2025-521045-24-00: CIRCULATE III - Tailoring the decision for adjuvant chemotherapy using circulating tumour DNA, in patients with stage III colorectal cancer
Protocol code: UC-GIG-2410
Sponsor: Unicancer (Hospital/Clinic/Other health care facility). Phase: Therapeutic confirmatory (Phase III). Countries: France (ongoing, recruiting), Sweden (authorised, recruitment pending).
Therapeutic area(s): Diseases [C] - Neoplasms [C04]
Gender: Female, Male. Age: 18-64 years, 65+ years. Enrolment: 300.
Start date (EU): 2026-07-31. Decision date: 2026-04-28. Results received: No. Last updated: 2026-04-30.
Decision dates by country: FR: 2026-04-30, SE: 2026-04-28

Condition(s): Stage III colorectal cancer
Product: Capecitabine Accord 150 mg film-coated tablets, Fluorouracil 25 mg/ml Solution for Injection or Infusion, Irinotecan Accord 20 mg/ml Solution à diluer pour perfusion, OXALIPLATINE ARROW LAB 5 mg/mL, solution à diluer pour perfusion, Leucovorin-Teva 10 mg/ml Concentrate for Solution for Infusion

Primary endpoint: The 3-year Disease-Free Survival (DFS) rate; DFS will be defined as time from randomization to first event (i.e, either a first recurrence local or metastatic (radiological or clinical), second colorectal cancer, or death from any cause). Patients alive without event will be censored at the date of the last follow-up (12). The 3-year DFS rate will be estimated using Kaplan Meier method.
Endpoint(s): Efficacy endpoints :Disease Free Survival will be defined as time from randomization to first event. Patients alive without event will be censored at the date of the last follow. Overall Survival defined as the time from the date of randomization to the date of documented death from any cause. Patients alive at the end of the study will be censored at the date of the last contact. Time to Recurrence is defined as the time from the date of randomization to the date of first recurrence, Safety endpoints :Safety of treatments (NCI-CTCAE version 6.0) will be determined through the incidence of adverse events (AEs), treatment related adverse events (TRAEs), serious adverse Events (SAE), and death. For ctDNA-negative cohort: Rate of neurotoxicity in each arm in de-escalation cohort (CAPOX vs CAPE), along with comparison between two arms of severity and duration of such neurotoxicity during treatment and at 1 year after treatment., Exploratory endpoints : Quality of life. Identify prognostication of stage III CRC by testing the added value of ctDNA on classical histoprognostic factors. Value of biological factors will be described by absolute or relative variation from baseline. To assess their prognostic or predictive values of DFS/OS, baseline values of these biomarkers will be tested using Cox reg model. For ctDNA-negative: Rate of ctDNA positivation. For ctDNA-positive: Rate of ctDNA negativation, Ancillary studies endpoints: To evaluate several ctDNA detection technics (methylation, sequencing…). To assess the incremental prognostic value contributed by various tumor molecular signatures relative to ctDNA status.

Source: https://euclinicaltrials.eu/ctis-public/view/2025-521045-24-00